EU clinical trial 2025-522547-17-00: PK/PD of Cefadroxil in Staphylococcus Aureus Bacteremia, a preliminary study
Sponsor: UZ Brussel (Hospital/Clinic/Other health care facility). Phase: Therapeutic exploratory (Phase II). Countries: Belgium (authorised, recruiting).
Therapeutic area(s): Diseases [C] - Bacterial Infections and Mycoses [C01]
Gender: Female, Male. Age: 18-64 years, 65+ years. Enrolment: 25.
Status: Authorised, recruiting. Start date (EU): 2026-01-04. Decision date: 2025-09-24. Results received: No. Last updated: 2026-05-06.

Condition(s): staphylococcus aureus bacteremia
Product: Cefadroxil Sandoz 500 mg harde capsules

Primary endpoint: PK Assessment: Establishment of correct cefadroxil doses through Monte Carlo simulations (serum concentrations > MIC for at least 50% of the day). PD Assessment: Therapeutic failure will be assessed as a composite endpoint of relapsing SAB, deep-seated infection with the same bacteria, switch to another antimicrobial regimen due to ad-verse events or failure to improve, attributable rehospitalization, or attributable mortality within 90 days of inclusion. Adverse Events (AE): Monitoring and re

Source: https://euclinicaltrials.eu/ctis-public/view/2025-522547-17-00